EU clinical trial 2024-515894-80-00: Safety and clinical parameter assessment of a 12-week home self-infusion therapy with Prolastin® in patients with severe alpha-1-antitrypsin (AATD) deficiency. The “Sunshine Study”
Protocol code: PPRO24-001
Sponsor: Grifols S.A. (Pharmaceutical company). Phase: Therapeutic confirmatory (Phase III). Countries: Germany (ongoing, recruiting).
Therapeutic area(s): Diseases [C] - Respiratory Tract Diseases [C08]
Gender: Female, Male. Age: 18-64 years, 65+ years. Enrolment: 33.
Status: Ongoing, recruiting. Start date (EU): 2025-07-01. Decision date: 2025-03-05. Results received: No. Last updated: 2026-07-08.

Condition(s): Severe Alpha-1 Antitrypsin Deficiency (AATD)
Product: Prolastin 1000 mg, Pulver und Lösungsmittel zur Her- stellung einer Infusionslösung, Prolastin 4000 mg, Pulver und Lösungsmittel zur Herstellung einer Infusionslösung, Prolastin 5000 mg, Pulver und Lösungsmittel zur Herstellung einer Infusionslösung

Primary endpoint: Occurrence of AEs during the training and/or main study period
Endpoint(s): SGRQ-C scores (Symptoms, Activity and Impacts scores) at baseline visit (V0) and end-of-study visit (EOS) as well as change between V0 and EOS, CAT total score at V0, at VT5 (if applicable), VM1, VM5, VM9, and EOS as well as changes to V0, COPD Assessment Test (CAT) total score at V0 and in main study period (VM1, VM5, VM9), and at EOS as well as changes to V0, Lung function parameters (Forced Expiratory Volume in the First Second [FEV1], Forced Vital Capacity [FVC], Diffusing Capacity of the Lungs for Carbon Monoxide [DLCO], Residual Volume [RV], Total Lung Capacity [TLC]) at V0 and EOS as well as change between V0 and EOS, Global Initiative for Chronic Obstructive Lung Disease (GOLD) grade for severity of airflow obstruction (GOLD A, B, E) at V0 and EOS as well as change between V0 and EOS, Patient satisfaction at each visit, Ease of use at each visit

Source: https://euclinicaltrials.eu/ctis-public/view/2024-515894-80-00